EU clinical trial 2024-518847-40-00: RECHALLENGE WITH PEGYLATED LIPOSOMAL DOXORUBICIN ADDED TO TRABECTEDIN IN RECURRENT OVARIAN CANCER: A MULTICENTER, PROSPECTIVE TRIAL.(REPRAB study- MITO 36)
Protocol code: REPRAB - MITO 36
Sponsor: Fondazione Policlinico Universitario Agostino Gemelli IRCCS (Hospital/Clinic/Other health care facility). Phase: Therapeutic exploratory (Phase II). Countries: Italy (ongoing, recruitment ended).
Therapeutic area(s): Diseases [C] - Neoplasms [C04]
Gender: Female. Age: 18-64 years, 65+ years. Enrolment: 64.
Status: Ongoing, recruitment ended. Start date (EU): 2021-07-16. Decision date: 2024-11-25. Results received: No. Last updated: 2025-09-02.

Condition(s): recurrent ovarian cancer
Product: Caelyx pegylated liposomal 2 mg/ml concentrate for solution for infusion, TRABECTEDIN

Primary endpoint: Response and progression will be evaluated according to the Response Evaluation Criteria in Solid Tumors (RECIST) version 1.1

Source: https://euclinicaltrials.eu/ctis-public/view/2024-518847-40-00